EU clinical trial 2023-508668-31-00: A pilot study of the safety and tolerability of oral administration of PD L 506 and the subsequent diagnostic value of porphyrin concentration (coproporphyrin I / III, CP I / III) in urine in patients with the first occurrence of colorectal cancer and in healthy subjects.
Protocol code: KRK 01
Sponsor: Photonamic GmbH & Co. KG (Pharmaceutical company). Phase: Therapeutic exploratory (Phase II). Countries: Germany (ongoing, recruiting).
Therapeutic area(s): Analytical, Diagnostic and Therapeutic Techniques and Equipment [E] - Diagnosis [E01]
Gender: Female, Male. Age: 18-64 years, 65+ years. Enrolment: 30.
Status: Ongoing, recruiting. Start date (EU): 2024-11-12. Decision date: 2024-08-20. Results received: No. Last updated: 2026-07-16.

Condition(s): Colorectal Carcinoma
Product: Gliolan 30 mg/ml powder for oral solution.

Primary endpoint: Number of Adverse Drug Reactions (ADRs) graded according to CTCAE v5.0., Number of discontinuations due to ADRs.
Endpoint(s): Change of CP I / III levels in CRC patient urine samples taken before PD L 506 administration to CP I / III levels in CRC patient urine samples collected 5 ± 1.0 hours after PD L 506 administration at the same day, at Visit 1 (before NAT, for NAT patients only) and Visit 2 (before tumour resection) and Visits 3, 4 and 6 (after NAT / tumour removal)., Change of CP I / III levels in CRC patient urine samples collected 5 ± 1.0 hours after PD L 506 administration before NAT / tumour removal (Visit 1 for NAT patients and Visit 2 for other patients) to after NAT / tumour removal (Visits 3, 4 and 6)., Change of CP I / III levels in healthy subject urine samples taken before PD L 506 administration to CP I / III levels in healthy subject urine samples collected 5 ± 1.0 hours after PD L 506 administration at the same day (Visit 2).

Source: https://euclinicaltrials.eu/ctis-public/view/2023-508668-31-00